EU clinical trial 2022-501439-18-00: A Phase 3, multicenter, randomized, open-label trial to compare the efficacy and safety of pembrolizumab (MK-3475) in combination with lenvatinib (E7080/MK-7902) versus docetaxel in previously treated participants with metastatic non-small cell lung cancer (NSCLC) and progressive disease (PD) after platinum doublet chemotherapy and immunotherapy (LEAP-008)
Protocol code: MK-7902-008
Sponsor: Merck Sharp & Dohme LLC (Pharmaceutical company). Phase: Therapeutic confirmatory (Phase III). Countries: France (ended), Italy (ended), Greece (ended), Spain (ended), Portugal (ended), Germany (ended), Hungary (ended).
Therapeutic area(s): Diseases [C] - Neoplasms [C04]
Gender: Female, Male. Age: 18-64 years, 65+ years. Enrolment: 206.
Status: Ended. Start date (EU): 2019-06-26. End date (EU): 2024-08-22. End date: 2024-08-23. Decision date: 2023-06-29. Results received: Yes. Last updated: 2024-08-01.
Decision dates by country: PT: 2023-06-29, HU: 2023-06-29, FR: 2023-07-10, IT: 2023-07-24, GR: 2023-07-26, ES: 2023-06-29, DE: 2023-07-06

Condition(s): NSCLC with squamous or nonsquamous histology
Product: Lenvatinib, Lenvatinib, KEYTRUDA 25 mg/mL concentrate for solution for infusion, DOCETAXEL

Primary endpoint: Overall Survival (OS), Progression-free Survival (PFS) Per Response Evaluation Criteria in Solid Tumors Version 1.1 (RECIST 1.1)
Endpoint(s): Objective Response Rate (ORR) Per Response Evaluation Criteria in Solid Tumors Version 1.1 (RECIST 1.1) - Pembrolizumab+Lenvatinib vs. Docetaxel, Objective Response Rate (ORR) Per Response Evaluation Criteria in Solid Tumors Version 1.1 (RECIST 1.1) - Pembrolizumab+Lenvatinib vs. Lenvatinib Monotherapy, Duration of Response (DOR) Per Response Evaluation Criteria in Solid Tumors Version 1.1 (RECIST 1.1), Number of Participants Experiencing an Adverse Event (AE), Number of Participants Discontinuing Study Treatment Due to an Adverse Event (AE), Change from Baseline in European Organization for Research and Treatment (EORTC) Quality of Life Questionnaire-Core 30 (QLQ-C30) Global Health Status / Quality of Life (Items 29 & 30) Scale Combined Score, Change from Baseline in EORTC Quality of Life Questionnaire Lung Cancer Module 13 (QLQ-LC13) Cough (Item 31) Scale Score, Change from Baseline in EORTC QLQ-LC13 Chest Pain (Item 40) Scale Score, Change from Baseline in EORTC QLQ-C30 Dyspnea (Item 8) Scale Score, Change from Baseline in EORTC QLQ-C30 Physical Functioning (Items 1 to 5) Scale Combined Score, Time to True Deterioration (TTD) in EORTC QLQ-C30 Global Health Status / Quality of Life (Items 29 & 30) Scale Combined Score, Time to True Deterioration (TTD) in EORTC QLQ-LC13 Cough (Item 31) Scale Score, Time to True Deterioration (TTD) in EORTC QLQ-LC13 Chest Pain (Item 40) Scale Score, Time to True Deterioration (TTD) in EORTC QLQ-C30 Dyspnea (Item 8) Scale Score, Time to True Deterioration (TTD) in EORTC QLQ-C30 Physical Functioning (Items 1 to 5) Scale Combined Score

Source: https://euclinicaltrials.eu/ctis-public/view/2022-501439-18-00